EU clinical trial 2025-522975-27-00: The pivotal bioequivalence study comparing the test product to the reference product, which belong to the group of medicines used in the treatment of type 2 diabetes mellitus when the condition cannot be adequately controlled by diet and exercise alone.
Protocol code: 1048/25
Sponsor: Adamed Pharma S.A. (Pharmaceutical company). Phase: Human Pharmacology (Phase I)- Bioequivalence Study. Countries: Czechia (ended).
Therapeutic area(s): Diseases [C] - Nutritional and Metabolic Diseases [C18]; Diseases [C] - Cardiovascular Diseases [C14]
Gender: Female, Male. Age: 18-64 years. Enrolment: 44.
Status: Ended. Start date (EU): 2025-09-29. End date (EU): 2025-12-16. Decision date: 2025-09-08. Results received: No. Last updated: 2025-11-24.

Condition(s): Not applicable (submitted trial is a BE study in healthy subjects).

Source: https://euclinicaltrials.eu/ctis-public/view/2025-522975-27-00